EU clinical trial 2025-521835-35-00: Impact of Glucagon on Physical Capacity and Metabolism
Protocol code: KKB_2025_GLUPAB
Sponsor: Katholisches Klinikum Bochum gGmbH (Hospital/Clinic/Other health care facility). Phase: Therapeutic exploratory (Phase II). Countries: Germany (ongoing, recruiting).
Therapeutic area(s): Diseases [C] - Nutritional and Metabolic Diseases [C18]
Gender: Female, Male. Age: 18-64 years, 65+ years. Enrolment: 47.
Status: Ongoing, recruiting. Start date (EU): 2025-11-14. Decision date: 2025-09-02. Results received: No. Last updated: 2026-03-06.

Condition(s): Heart Failure with preserved Ejection Fraction (HFpEF) with or without concomitant Metabolic Dysfunction Associated Steatotic Liver Disease (MASLD)
Product: Human-Albumin 20 % Behring, salzarm Infusionslösung, GlucaGen 1 mg, Pulver und Lösungsmittel zur Herstellung einer Injektionslösung, GlucaGen HypoKit 1mg, Pulver und Lösungsmittel zur Herstellung einer Injektionslösung

Primary endpoint: Change in VO2max (ml/kg/min) during 4 hours of continuous subcutaneous administration of glucagon at a dose of 20 ng/kg/min.
Endpoint(s): Change in energy expenditure (kcal/min) or substrate utilisation (respiratory exchange ratio) during a 4-hour continuous subcutaneous infusion of glucagon at a dose of 20 ng/kg/min, Plasma bioavailability of glucagon (area under the curve, Cmax, Tmax) and change in plasma ketone body concentration (Cmax) during a 4-hourly continuous subcutaneous infusion of glucagon at a dose of 20 ng/kg/min.

Source: https://euclinicaltrials.eu/ctis-public/view/2025-521835-35-00